EU clinical trial 2023-508610-42-00: Effect of the SGLT2 inhibitor empagliflozin in patients with euvolemic and hypervolemic hyponatremia – a multicentric randomized double-blind placebo-controlled trial (the EMPOWER Study)
Protocol code: EKNZ-2020-01917
Sponsor: Universitaetsspital Basel (Hospital/Clinic/Other health care facility). Phase: Therapeutic exploratory (Phase II). Countries: Germany (ongoing, recruiting), Netherlands (ongoing, recruiting).
Therapeutic area(s): Diseases [C] - Hormonal diseases [C19]
Gender: Female, Male. Age: 18-64 years, 65+ years. Enrolment: 60.
Status: Ongoing, recruiting. Start date (EU): 2025-10-17. Decision date: 2025-04-29. Results received: No. Last updated: 2026-07-17.
Decision dates by country: DE: 2025-04-30, NL: 2025-04-29

Condition(s): Hyponatremia
Product: Jardiance 25 mg film-coated tablets, P-Tabletten weiß 10 mm Lichtenstein

Primary endpoint: The short-term outcome is the change in average daily area under the curve (AUC) for plasma sodium concentration from baseline (day 0) to day 4., The long-term outcomes is the change in plasma sodium concentration from baseline to day 30
Endpoint(s): Short (day 1, day 2, day 3, day of discharge term course of plasma sodium level, Urine sodium, eGFR, serum and urine -osmolality, -potassium, -creatinine, -urea, -uric acid, -glucose, -CRP at baseline, on day 4, and day 30, Blood and urine aliquots on day 0, day 1, day 4 and day 30, including predefined analysis: markers of salt-water balance (MR-proANP, NT-proBNP, copeptin, aldosteron, renin) and markers of bone metabolism (procollagen type I N propeptide (P1NP) and serum C telopeptide (CTX), Daily fluid intake (mL) from baseline (day 0) to day 4, Change in body weight (including AUC 24h – 4 days), blood pressure and heart rate twice a day at baseline (day 0) and on day 1 and then once a day on day 2, day 3, day 4, and day 30, Course of thirst and symptoms of hyponatremia assessed on a yes or no basis: headache, vertigo and nausea at baseline (day 0), on day 4 and day 30, Course of general well-being rated by patients on a visual analogue scale (VAS) reaching from 0 (no well-being) to 10 (excellent well-being) at baseline (day 0), on day 4 and day 30, Change in quality of life assessed by the EQ-5D-5L questionnaire at baseline (day 0), on day 4 and day 30, Change in neurocognitive functions assessed by the MoCA Test and the Trail Making Test A and B at baseline (day 0), on day 4 and day 30, Change in gait stability assessed by the Timed Up and Go Test at baseline (day 0), on day 4 and day 30, Fall as admission (co)-diagnosis at baseline or as re-admission (co)-diagnosis during treatment period (Day 0 – Day 30), Incidence of fractures during the twelve months prior to treatment start, fractures as admission (co)-diagnosis at baseline or as re-admission (co)-diagnosis during treatment period (Day 0 – Day 30), Grip strength measured with a hand dynamometer at baseline (day0), on day 4 and day 30, Percentage of patients with plasma sodium concentration that has normalized after 4, on day of discharge) and after 30 days of treatment, Duration (days) until normonatremia has been reached, Recurrence-rate of hyponatremia during treatment period (Day 0 – Day 30), Recurrence of hyponatremia after treatment completion according to plasma sodium measurement at follow up (day 37 +21/- 3 days), Need for additional hyponatremia treatment and treatment escalation (e.g. administration of 3% NaCl infusion) during treatment period (Day 0 – Day 30), Rate of ICU-admissions during treatment period (Day 0 – Day 30), Length of hospital stay (days), Rate of readmission due to hyponatremia and other causes during treatment period (Day 0 – Day 30), Baseline characteristics including age, gender, medical history, medication, date of hospitalisation and admission diagnosis.

Source: https://euclinicaltrials.eu/ctis-public/view/2023-508610-42-00